EU clinical trial 2024-518321-15-00: A Multicentre, Randomized, Double-Blind, Placebo Controlled, Dose Finding, Parallel Group, Phase 2 study of an anti-TSLP Antibody (GSK5784283) in Adults aged 18 to 75 years of age with Uncontrolled Asthma
Protocol code: 223125
Sponsor: Glaxosmithkline Research & Development Limited (Pharmaceutical company). Phase: Therapeutic exploratory (Phase II). Countries: Bulgaria (ongoing, recruitment ended), Czechia (ongoing, recruitment ended), Germany (ongoing, recruitment ended), Spain (ongoing, recruitment ended), Romania (ongoing, recruitment ended).
Therapeutic area(s): Diseases [C] - Respiratory Tract Diseases [C08]
Gender: Female, Male. Age: 18-64 years, 65+ years. Enrolment: 136.
Status: Ongoing, recruitment ended. Start date (EU): 2025-05-30. Decision date: 2025-04-30. Results received: No. Last updated: 2026-07-28.
Decision dates by country: CZ: 2025-04-30, RO: 2025-05-05, BG: 2025-05-02, ES: 2025-05-06, DE: 2025-05-02

Condition(s): Asthma
Product: Placebo for GSK5784283.

Primary endpoint: FeNO (ppb) over 26 Weeks.
Endpoint(s): Part A Dose Finding: Blood eosinophil counts over 26 Weeks., Part A Dose Finding: Lung function as measured by pre-and postbronchodilator forced expiratory volume (FEV1) and forced vital capacity (FVC) over 26 Weeks., Part A Dose Finding: Asthma Control Questionnaire (ACQ-5) over 26 Weeks., Part A Dose Finding: Maximum change from baseline in FeNO, blood eosinophil count, FEV1 and ACQ-5 over 26 Weeks, Part A Dose Finding: PK parameters of GSK5784283: maximum value (Cmax), time of Cmax (tmax), and area under the curve over the dosing interval (AUC0-tau) at Week 26, Part B Extension: Change from baseline in FeNO and blood eosinophil counts at Week 52 and other prespecified timepoints according to SoA, Part B Extension: Change from baseline in lung function as measured by pre- and post-bronchodilator FEV1 and FVC at Week 52 and other pre-specified timepoints according to SoA, Part B Extension: Change from baseline in ACQ-5 at Week 52 and other pre-specified timepoints according to the SoA, Part B Extension: Ratio to baseline in FeNO and blood eosinophil counts at Week 52 and other pre-specified timepoints according to SoA

Source: https://euclinicaltrials.eu/ctis-public/view/2024-518321-15-00